EU clinical trial 2023-508261-32-00: A Phase I/IIa open label single ascending dose study to assess safety and tolerability of regulatory T cells to promote discontinuation of tacrolimus monotherapy in liver transplant recipients - LiveTreg
Protocol code: LiveTreg
Sponsor: Charite Universitaetsmedizin Berlin KöR (Hospital/Clinic/Other health care facility). Phase: Phase I and Phase II (Integrated)- Other. Countries: Germany (ongoing, recruiting).
Therapeutic area(s): Analytical, Diagnostic and Therapeutic Techniques and Equipment [E] - Therapeutics [E02]
Gender: Female, Male. Age: 18-64 years, 65+ years. Enrolment: 27.
Status: Ongoing, recruiting. Start date (EU): 2025-07-21. Decision date: 2025-02-06. Results received: No. Last updated: 2025-08-14.

Condition(s): Solid organ transplantation (Liver)
Product: Advagraf 1 mg prolonged-release hard capsules, Histakut Dimetindenmaleat 1 mg/ml Injektionslösung, Paracetamol-ratiopharm® 500 mg Tabletten, Envarsus 1 mg prolonged-release tablets, Prograf 0,5 mg Hartkapseln, Treg02

Primary endpoint: Primary safety endpoint 1: Acute toxicity associated with infusion of Treg02 will be assessed by evidence of: (a) pulmonary complications, (b) immunological reactions resulting in anaphylactic reactions, immediate cardiovascular compromise, or other acute organ failure, (c) Treg therapy associated biochemical perturbation (significant deviations in biomarker data) as assessed by the immunological impact of the infused cells or apoptosis of Tregs and release of cellular contents, Primary safety endpoint 2: Over-suppression of the immune system by assessing evidence of: (a) major and/or opportunistic infections, especially increased frequency of CMV, EBV and HBV, HCV reactivation and/or disease, (b) (early) development of neoplasia, (c) relevant anomalies in laboratory analysis unrelated to the transplanted liver functions, Primary clinical endpoint: Incidence of acute and/or chronic rejection and the prevalence of AEs. The principal measure of immunomodulation is biopsy-proven acute rejection (BPAR) within 14 months following Treg transfer. Histopathological grading of biopsy material will be assessed by the established Banff criteria.
Endpoint(s): Secondary indices of efficacy 1: Prevention of acute rejection: (a) Time to acute rejection episode, (b) Severity of acute rejection episodes based on response to treatment and histological scoring, (c) The level of total immunosuppression at the final trial visit, Secondary indices of efficacy 2: Incidence of patients treated for subclinical acute rejection based on histopathological findings, Secondary indices of efficacy 3: Prevention of chronic graft dysfunction (chronic rejection) will be assessed by clinically impaired levels of liver enzymes) and histopathological (Banff staging) criteria measures, Secondary indices of efficacy 4: Reduced incidence of adverse events/rejections following tapering of immunosuppression (e.g. cardiovascular complications, drug toxicity, etc.), Biomarker panel: Measure functional and molecular indices reflecting the immune response as well as treatment safety and efficacy of Tregs by a validated set of biomarkers; as detailed in the Clinical trial protocol., Assess health-related quality of life by the SF-12 questionnaire

Source: https://euclinicaltrials.eu/ctis-public/view/2023-508261-32-00